EU clinical trial 2023-506241-30-00: A Randomized Phase 3 Study of MRTX849 in Combination with Cetuximab Versus Chemotherapy in Patients with Advanced Colorectal Cancer with KRAS G12C Mutation with Disease Progression On or After Standard First-Line Therapy
Protocol code: 849-010
Sponsor: Mirati Therapeutics Inc. (Pharmaceutical company). Phase: Therapeutic confirmatory (Phase III). Countries: Denmark (ongoing, recruitment ended), Italy (ongoing, recruitment ended), Ireland (ended), Czechia (ended), Spain (ongoing, recruitment ended), Belgium (ended), Portugal (ended), Romania (ended), Germany (ongoing, recruitment ended), Finland (ended), Netherlands (ended), Austria (ended), France (ongoing, recruitment ended), Greece (ended), Poland (ended).
Therapeutic area(s): Diseases [C] - Neoplasms [C04]
Gender: Female, Male. Age: 18-64 years, 65+ years. Enrolment: 199.
Start date (EU): 2021-11-30. Decision date: 2023-12-11. Results received: No. Last updated: 2026-07-17.
Decision dates by country: FR: 2023-12-22, RO: 2023-12-15, BE: 2023-12-11, AT: 2023-12-15, FI: 2023-12-15, PL: 2024-01-26, DK: 2023-12-11, CZ: 2023-12-12, PT: 2023-12-11, IE: 2023-12-11, ES: 2023-12-11, DE: 2023-12-12, GR: 2024-01-22, NL: 2023-12-12, IT: 2023-12-13

Condition(s): Advanced Colorectal Cancer with KRAS G12C Mutation
Product: Erbitux 5 mg/mL solution for infusion, FLUOROURACIL, Adagrasib, AFLIBERCEPT, OXALIPLATIN, CALCIUM FOLINATE, Erbitux 5 mg/mL solution for infusion, RAMUCIRUMAB, IRINOTECAN, BEVACIZUMAB

Primary endpoint: Overall Survival (OS), Progression-free Survival (PFS)
Endpoint(s): Adverse Events, Objective Response Rate (ORR), Duration of Response (DOR), Patient Reported Outcomes (PROs), Quality of Life Assessment

Source: https://euclinicaltrials.eu/ctis-public/view/2023-506241-30-00